EU clinical trial 2024-512895-36-00: A Phase 3, Randomized, Double-Blind, Placebo-Controlled Study Evaluating the Safety and Efficacy of Efruxifermin in Subjects with Compensated Cirrhosis Due to Nonalcoholic Steatohepatitis (NASH)/Metabolic Dysfunction-Associated Steatohepatitis (MASH)
Protocol code: AK-US-001-0106
Sponsor: Akero Therapeutics Inc. (Pharmaceutical company). Phase: Therapeutic confirmatory (Phase III). Countries: France (ongoing, recruiting), Italy (ongoing, recruiting), Germany (ongoing, recruiting), Spain (ongoing, recruiting), Poland (ongoing, recruiting), Greece (authorised, recruitment pending).
Therapeutic area(s): Diseases [C] - Nutritional and Metabolic Diseases [C18]
Gender: Female, Male. Age: 18-64 years, 65+ years. Enrolment: 189.
Start date (EU): 2024-11-25. Decision date: 2024-10-11. Results received: No. Last updated: 2026-07-29.
Decision dates by country: ES: 2024-10-14, FR: 2024-10-11, DE: 2024-10-11, GR: 2026-06-29, IT: 2024-10-11, PL: 2025-11-30

Condition(s): Metabolic Dysfunction-Associated Steatohepatitis (MASH), Non Alcoholic Steatohepatitis (NASH)
Product: Efruxifermin, Efruxifermin (EFX) placebo

Primary endpoint: The primary clinical outcomes analysis will be EFS. EFS will be assessed by time from randomization to the first clinical event including evidence of disease progression, liver decompensation events, liver transplantation or eligibility for liver transplantation, and all-cause mortality., Primary Endpoint at Week 96 based on liver biopsy (Cohort 1 only): An interim analysis of the histology primary efficacy endpoint is planned when all subjects in Cohort 1 complete the Week 96 visit. A CMH test will be used to compare the differences in proportions of subjects who achieve a ≥ 1 stage improvement in fibrosis without worsening of steatohepatitis at Week 96 between the EFX arm and the placebo arm.
Endpoint(s): Change from baseline in ELF score and components (tissue inhibitor of metalloproteinase-1 [TIMP-1], hyaluronic acid [HA], amino terminal pro-peptide of type 3 procollagen [PIIINP]), pro-peptide of type 3 procollagen (Pro-C3), and liver stiffness assessed by FibroScan at Week 96 and over time through study completion, Change from baseline in ALT and AST at Week 96 and over time through study completion, Change from baseline in total cholesterol, TG, high density lipoprotein cholesterol (HDL-C), non-HDL-C, and low-density lipoprotein cholesterol (LDL-C) at Week 96 and over time through study completion, Change from baseline in HbA1c, C-peptide, adiponectin, insulin, and HOMA-IR at Week 96 and over time through study completion, Change from baseline in body weight at Week 96 and over time through study completion, Cohort 1 only: Proportion of subjects who achieve ≥ 1 stage improvement in fibrosis (based on NASH CRN fibrosis score) at Week 96, Cohort 1 only: Proportion of subjects with NASH/MASH resolution (defined as a NAS of 0–1 for inflammation and 0 for ballooning) as determined by the NASH CRN criteria at Week 96, Cohort 1 only: Proportion of subjects who achieve NASH/MASH resolution (defined as a NAS of 0–1 for inflammation and 0 for ballooning) AND ≥ 1 stage improvement in fibrosis (based on NASH CRN fibrosis score) at Week 96

Source: https://euclinicaltrials.eu/ctis-public/view/2024-512895-36-00